EU clinical trial 2025-523922-42-00: Randomized, multicenter, open-label clinical trial to evaluate the clinical and microbiological impact of methenamine hippurate as an alternative prophylaxis to antibiotics in the management of recurrent urinary tract infections in women
Protocol code: RUTI-MET
Sponsor: Consorci Mar Parc De Salut De Barcelona (Hospital/Clinic/Other health care facility). Phase: Therapeutic use (Phase IV). Countries: Spain (authorised, recruitment pending).
Therapeutic area(s): Diseases [C] - Female Urogenital Diseases and Pregnancy Complications [C13]
Gender: Female. Age: 18-64 years, 65+ years. Enrolment: 204.
Status: Authorised, recruitment pending. Decision date: 2026-03-25. Results received: No. Last updated: 2026-06-18.

Condition(s): recurrent urine infections
Product: METHENAMINE HIPPURATE, SEPTRIN 80 mg/400 mg comprimidos., CEFALEXIN, FOSFOMYCIN TROMETAMOL

Primary endpoint: Primary clinical variable: number of recurrent symptomatic UTI episodes during the 6-month treatment period. Primary microbiological variable: number of patients with isolates showing an MDR (multidrug-resistant) profile at 6 months of treatment.
Endpoint(s): Number of symptomatic UTI episodes at 12 months of follow-up., Percentage of severe infection episodes (urosepsis and/or septic shock), bacteremia, and hospitalizations due to UTI during the treatment period (6 months) and the follow-up period (12 months)., Patient satisfaction assessed through general and UTI-specific quality-of-life questionnaires., Percentage of adverse events by organ system and their intensity., Number of antibiotic courses during follow-up., Percentage of patients with isolates showing a DTR (difficult-to-treat resistance) profile, ESBL-producing isolates, or carbapenemase-producing isolates in both groups., Percentage of alpha and beta diversity in the vaginal microbiota according to study group.

Source: https://euclinicaltrials.eu/ctis-public/view/2025-523922-42-00